EU clinical trial 2024-519316-13-00: A Phase 1 Randomized, Placebo-Controlled, Double-Blind Study of the Safety, Tolerability and Pharmacological Effects of PT00114 in Healthy Volunteers
Protocol code: PT00114-001A
Sponsor: Protagenic Therapeutics Inc. (Pharmaceutical company). Phase: Human Pharmacology (Phase I)- First administration to humans. Countries: Germany (ended).
Therapeutic area(s): Psychiatry and Psychology [F] - Mental Disorders [F03]
Gender: Female, Male. Age: 18-64 years, 65+ years. Enrolment: 24.
Status: Ended. Start date (EU): 2025-08-01. End date (EU): 2025-09-24. Decision date: 2025-07-02. Results received: No. Last updated: 2025-07-24.
Decision dates by country: DE: 2025-07-24

Condition(s): Phase I study in healthy male and female volunteers. Intended indication: mood disorders

Source: https://euclinicaltrials.eu/ctis-public/view/2024-519316-13-00